EU clinical trial 2024-513404-34-00: INTEGRATION OF PHARMACOCINETIC AND NEUROMETABOLIC DATA WITH FUNCTIONAL MRI FOR DETECTION AND QUANTIFICATION OF THE CENTRAL EFFECTS OF PARACETAMOL (IMAntalgique)
Protocol code: 100 073
Sponsor: Commissariat à l’Energie Atomique et aux Energies Alternatives (Industry). Phase: Therapeutic exploratory (Phase II). Countries: France (ongoing, recruiting).
Therapeutic area(s): Analytical, Diagnostic and Therapeutic Techniques and Equipment [E] - Anesthesia and Analgesia [E03]
Gender: Male. Age: 18-64 years. Enrolment: 48.
Status: Ongoing, recruiting. Start date (EU): 2025-09-12. Decision date: 2024-11-05. Results received: No. Last updated: 2024-11-05.

Condition(s): healthy volunteer

Source: https://euclinicaltrials.eu/ctis-public/view/2024-513404-34-00